EU clinical trial 2023-504962-52-00: A Phase 3, Randomized, Open-label, Study to Compare the Efficacy and Safety of Adjuvant MK-2870 in Combination with Pembrolizumab (MK-3475) Versus Treatment of Physician’s Choice (TPC) in Participants With Triple-Negative Breast Cancer (TNBC) Who Received Neoadjuvant Therapy and Did Not Achieve a Pathological Complete Response (pCR) at Surgery
Protocol code: MK-2870-012
Sponsor: Merck Sharp & Dohme LLC (Pharmaceutical company). Phase: Therapeutic confirmatory (Phase III). Countries: Italy (ongoing, recruiting), Finland (ongoing, recruiting), Spain (ongoing, recruiting), Belgium (ongoing, recruiting), Austria (ongoing, recruiting), Poland (ongoing, recruiting), Germany (ongoing, recruiting), Greece (ongoing, recruiting), France (ongoing, recruiting), Czechia (ongoing, recruiting), Norway (ongoing, recruiting), Ireland (ongoing, recruiting), Portugal (ongoing, recruiting), Denmark (ongoing, recruiting), Sweden (ongoing, recruiting).
Therapeutic area(s): Diseases [C] - Neoplasms [C04]
Gender: Female, Male. Age: 18-64 years, 65+ years. Enrolment: 631.
Status: Ongoing, recruiting. Start date (EU): 2024-07-10. Decision date: 2024-06-11. Results received: No. Last updated: 2026-07-13.
Decision dates by country: FI: 2024-06-13, NO: 2024-06-14, PT: 2024-06-18, AT: 2024-06-17, CZ: 2024-06-12, IT: 2024-06-12, FR: 2024-06-13, PL: 2024-06-14, SE: 2025-08-13, DK: 2025-09-04, ES: 2024-06-11, IE: 2024-06-14, GR: 2024-06-17, BE: 2024-06-11, DE: 2024-06-12

Condition(s): Triple negative breast cancer.
Product: PARACETAMOL, CAPECITABINE, KEYTRUDA 25 mg/mL concentrate for solution for infusion, MK-2870, DEXAMETHASONE

Primary endpoint: Invasive Disease-Free Survival (iDFS)
Endpoint(s): Overall Survival (OS), Distant Recurrence-Free Survival (DRFS), Change from Baseline in European Organisation for Research and Treatment of Cancer Quality of Life Questionnaire-Core 30 (EORTC QLQ-C30) Global Health Status (Item 29) and Quality of Life (Item 30) Combined Score, Change from Baseline in European Organisation for Research and Treatment of Cancer Quality of Life Questionnaire-Core 30 (EORTC QLQ-C30) Physical Functioning (Items 1-5) Score, Change from Baseline in European Organisation for Research and Treatment of Cancer Quality of Life Questionnaire-Core 30 (EORTC QLQ-C30) Role Functioning (Items 6 and 7) Score, Change from Baseline in European Organisation for Research and Treatment of Cancer Quality of Life Questionnaire-Core 30 (EORTC QLQ-C30) Fatigue (Items 10, 12, 18) Score, Number of Participants Who Experience One or More Adverse Events (AEs), Number of Participants Who Discontinue Study Intervention Due to an AE

Source: https://euclinicaltrials.eu/ctis-public/view/2023-504962-52-00